EU clinical trial 2024-511998-30-00: A Randomized, Double-Blind, Placebo-Controlled Study to Evaluate the Efficacy and Safety of TAK-861 for the Treatment of Narcolepsy with Cataplexy (Narcolepsy Type 1)
Protocol code: TAK-861-3002
Sponsor: Takeda Development Center Americas Inc. (Pharmaceutical company). Phase: Therapeutic confirmatory (Phase III). Countries: Denmark (ended), Finland (ended), France (ended), Austria (ended), Sweden (ended), Czechia (not authorised), Italy (ended), Belgium (ended), Hungary (ended), Spain (ended), Poland (ended).
Therapeutic area(s): Diseases [C] - Nervous System Diseases [C10]
Gender: Female, Male. Age: 18-64 years, 65+ years. Enrolment: 80.
Status: Ended. Start date (EU): 2024-10-18. End date (EU): 2025-05-30. End date: 2025-06-04. Decision date: 2024-10-03. Results received: Yes. Last updated: 2025-04-07.
Decision dates by country: CZ: 2024-10-07, DK: 2024-10-04, PL: 2024-10-07, FI: 2024-10-03, ES: 2024-11-13, HU: 2024-10-04, BE: 2024-10-07, AT: 2024-10-07, FR: 2024-10-03, IT: 2024-10-08, SE: 2024-10-04

Condition(s): Narcolepsy with Cataplexy (Narcolepsy Type 1)
Product: TAK-861, TAK-861 placebo (same excipients as TAK-861)

Primary endpoint: Change from baseline to Week 12 in ESS total score
Endpoint(s): Change from baseline to Week 12 in mean sleep latency from the 4 MWT wake trials., WCR at Week 12, Change from baseline to Week 12 in mean number of lapses on the, PGI-C score at Week 12., Change from baseline to Week 12 in NSS-CT total score, Change from baseline to Week 12 in FINI domain scores for: Tiredness, Cognitive Functioning, Cataplexy, Social Activities, Everyday Activities, and Everyday Responsibilities., Change from baseline to Week 12 in SF-36 mental and physical component summary scores, Occurrence of at least 1 TEAE during the study including the follow-up period, as applicable

Source: https://euclinicaltrials.eu/ctis-public/view/2024-511998-30-00